EU clinical trial 2024-516257-44-00: A multi-center open-label phase 2 study of Ixazomib, Iberdomide and dexamethasone in elderly patients with multiple myeloma at first relapse
Protocol code: RC21_0169 IFM2021-03
Sponsor: Centre Hospitalier Universitaire De Nantes (Hospital/Clinic/Other health care facility). Phase: Therapeutic exploratory (Phase II). Countries: France (authorised, recruitment pending).
Therapeutic area(s): Not possible to specify
Gender: Female, Male. Age: 65+ years. Enrolment: 80.
Status: Authorised, recruitment pending. Decision date: 2024-11-05. Results received: No. Last updated: 2026-06-10.

Condition(s): Multiple myeloma
Product: IBERDOMIDE 1.6mg, IBERDOMIDE 1.3mg, IDERDOMIDE 1mg, ixazomib citrate, Dexaméthasone, IDERDOMINE 0.75mg

Primary endpoint: The primary endpoint is the VGPR rate or better (as best response) using IMWG criteria
Endpoint(s): Number of adverse events defined by Common Terminology Criteria for Adverse Events (v5), ORR including Partial Response (PR), Very Good Partial Response (VGPR), Complete Response (CR) and minor response (MR) to Iberdomide Ixazomib and Dexamethasone will be evaluated according to IMWG criteria at 3 months and 6 months of treatment, Time to progression (TTP) is defined as the time in months from inclusion to the date of disease progression or death due to any cause. Subject alive or lost to follow-up without experiencing documented disease progression will be censored at the date of last valid disease and response assessment., Time to response (TTR) is defined as the time from inclusion to the date of the first response (PR or better), Duration of Response (DOR) is defined as the time from the first response (PR or better) to the date of disease progression or death due to any cause. Subject alive or lost to follow-up without experiencing documented disease progression will be censored at the date of last valid disease and response assessment., Duration of therapy (DOT) is defined as the time from treatment initiation to the last dose of therapy, Fragilty scores (IMWG, IFM Kumar Lancet Oncol 2016) will be assessed at time of inclusion, Overall Survival (OS) is defined as the time in months from inclusion to the date of death due to any cause. Subject alive will be censored at the last known alive date., Value of biological prognostic factors as ISS stage, cytogenetic as del(17p), t(4;14), t(14;16), t(14;20), amp(1q) and del(1p) will be explored. Bone marrow aspirate will be performed at baseline to support translational research project including: plasma cell profiling (cereblon, CD38, CD55, CD59 expression), immunoprofiling (T-cell (CD4, CD8) and NK-cell phenotype), Quality of life (EQ5D and SF36 scales will be used to assess QOL)

Source: https://euclinicaltrials.eu/ctis-public/view/2024-516257-44-00